EU clinical trial 2024-516224-34-00: EFFIPEC – Efficacy of Hyperthermic Intraperitoneal Chemotherapy Single-arm Phase I study, followed by an open-label, randomized, controlled registry-based phase III trial
Protocol code: EFFIPEC01
Sponsor: Uppsala University (Educational Institution). Phase: Therapeutic confirmatory (Phase III). Countries: Sweden (ongoing, recruiting).
Therapeutic area(s): Diseases [C] - Neoplasms [C04]
Gender: Female, Male. Age: 18-64 years, 65+ years. Enrolment: 163.
Status: Ongoing, recruiting. Start date (EU): 2024-08-16. Decision date: 2024-08-16. Results received: No. Last updated: 2026-04-13.

Condition(s): Colorectal cancer
Product: IRINOTECAN, FLUOROURACIL

Primary endpoint: Phase I: Maximum tolerated dose of 5-FU 24-hour EPIC, assessed until 30 days post-treatment. Possible toxicity will be reported as Adverse Events., Phase III: Local control rate within 24 months – Defined as peritoneal or liver recurrence. Retroperitoneal llg not included in this definition.
Endpoint(s): To evaluate the overall survival and RFS up to 5 years through the HIPEC registry., To evaluate postoperative complication rates within 30 days., To evaluate the quality of life of patients up to 3 years after treatment.

Source: https://euclinicaltrials.eu/ctis-public/view/2024-516224-34-00